EU clinical trial 2023-509891-40-00: COMMODITIES : Comparison of initial dual oral COMbination therapy to MOnotherapy in pulmonary arterial hypertension with cardiovascular comorbiDITIES
Protocol code: APHP230847
Sponsor: Assistance Publique Hopitaux De Paris (Hospital/Clinic/Other health care facility). Phase: Therapeutic confirmatory (Phase III). Countries: France (ongoing, recruiting).
Therapeutic area(s): Diseases [C] - Respiratory Tract Diseases [C08]; Diseases [C] - Cardiovascular Diseases [C14]
Gender: Female, Male. Age: 18-64 years, 65+ years. Enrolment: 186.
Status: Ongoing, recruiting. Start date (EU): 2026-04-28. Decision date: 2025-08-04. Results received: No. Last updated: 2026-01-23.

Condition(s): Pulmonary arterial hypertension
Product: Ambrisentan Viatris 5 mg film-coated tablets, Placebo de AMBRISENTAN VIATRIS 5 mg - composition: cellulose microcristalline; lactose monohydraté; silice colloïdale anhydre; stéarate de magnésium (vegetable origin); opadry II 85G94065 PINK; eau purifiée, TADALAFIL

Primary endpoint: Proportion of patients with PAH and cardiovascular comorbidities who achieve after 6 months a low- or an intermediate-low risk profile according to the non-invasive 4-risk strata method as proposed by the 2022 European pulmonary hypertension guidelines.
Endpoint(s): • Change in pulmonary vascular resistance, • Percent change in BNP or NT-proBNP, • Change in 6-minute walk distance, • Proportion of participants who improve in WHO/NYHA FC at the end of the DBPC Treatment Period, • Change in the TAPSE/systolic pulmonary artery pressure (SPAP) ratio, • Rate of Death or Nonfatal Clinical Worsening defined by hospitalisation for PAH worsening or disease progression defined by worsening of functional class and decrease in 6-min walk distance of more than 15% from baseline, or need for additional specific therapy or lung transplantation., • Change in the emPHasis10 score, • Change in the EuroQoL-5 dimensions scale 5 levels (EQ-5D-5L), • All causes of death, • Change in other hemodynamic parameters, • Change in other echocardiographic parameters, • Change of WHO/NYHA functional class, • Rate of death due to PAH, • Treatment-emergent adverse events (AEs), • Treatment-emergent serious AEs (SAES), • Treatment-emergent deaths, • AEs leading to premature discontinuation of study drug, • Change in laboratory variables, • Change in weight and vital signs (arterial blood pressure, heart rate).

Source: https://euclinicaltrials.eu/ctis-public/view/2023-509891-40-00